EU clinical trial 2022-500721-32-01: A phase II study evaluating the efficacy and safety of IMetelstat in Patients with HR myElodysplastic SyndromeS or AML failing HMA-based therapy.
Protocol code: IMpress_001
Sponsor: Gcp-Service International West GmbH (Pharmaceutical company). Phase: Therapeutic exploratory (Phase II). Countries: France (ended), Germany (ongoing, recruitment ended).
Therapeutic area(s): Diseases [C] - Neoplasms [C04]; Diseases [C] - Hemic and Lymphatic Diseases [C15]
Gender: Female, Male. Age: 18-64 years, 65+ years. Enrolment: 30.
Start date (EU): 2023-05-03. Decision date: 2023-04-26. Results received: No. Last updated: 2026-03-27.
Decision dates by country: FR: 2023-04-26, DE: 2023-04-26

Condition(s): AML and MDS patients failing or being refractory to hypomethylating agent (HMA)-based treatment
Product: HYDROCORTISONE, IMETELSTAT, DIPHENHYDRAMINE

Primary endpoint: • Overall response rate assessed after 4 months of treatment Using combined response assessment criteria for MDS and AML based on IWG 2018 criteria (MDS)1 and the criteria of the European LeukemiaNet (AML)2, as defined in Appendix III a), section 16.3.
Endpoint(s): • Toxicity as measured by NCI CTCAE v5.0, • Overall survival - defined as the time from the beginning of imetelstat treatment until death or censored at the date of the last follow-up visit., • Progression-free-survival - defined as the duration of time from time of imetelstat treatment to time of progression or death, whichever occurs first. A subject who has neither progressed nor died will be censored on the date of last follow-up visit., • Duration of best overall response - measured from the time measurement criteria are met for CR, CRri, PR or SD (whichever is recorded first, defined in Appendix III a), section 16.3) until the first date at which recurrent or progressive disease is objectively documented., • Best overall response - defined as the best response recorded from the start of the imetelstat treatment until disease progression (taking as reference for progressive disease the smallest measurements recorded since the treatment started)., • Scores of EORTC QLQ-C30 (version 3) - Global health status / QoL - Functional scales - Symptom scales / items, Response based on IWG 2023 criteria (MDS population only) assessed in week 17 (in C5, V9) of treatment with imetelstat, for definition see Appendix III b).

Source: https://euclinicaltrials.eu/ctis-public/view/2022-500721-32-01